EU clinical trial 2024-519977-20-00: French prospective open label phase II randomized non-comparative study of SC tocilizumab associated with IV pulse steroid versus IV pulse steroid alone for the treatment of acute anterior ischemic optic neuropathy associated with giant cell arteritis. (TOCIAION)
Protocol code: P17-03
Sponsor: Centre Hospitalier National D'Ophtalmologie Quinze-Vingts (Hospital/Clinic/Other health care facility). Phase: Therapeutic exploratory (Phase II). Countries: France (ended).
Therapeutic area(s): Diseases [C] - Eye Diseases [C11]; Diseases [C] - Cardiovascular Diseases [C14]
Gender: Female, Male. Age: 18-64 years, 65+ years. Enrolment: 58.
Status: Ended. Start date (EU): 2025-01-27. End date (EU): 2025-09-24. Decision date: 2025-01-27. Results received: No. Last updated: 2025-01-27.

Condition(s): Acute Anterior Ischemic Optic Neuropathy associated with Giant Cell Arteritis in Horton's Disease
Product: RoActemra 162 mg solution for injection in pre-filled syringe., SOLUMEDROL 1 g, poudre et solvant pour solution injectable, PREDNISONE VIATRIS 20 mg, comprimé sécable

Primary endpoint: The primary endpoint will be the ocular improvement at W8. This improvement will be defined as the increase of at least two lines of visual acuity on the ETDRS chart.
Endpoint(s): Stabilization of vision, as judged at W8 after treatment start, correspond to a lack of improvement (cf primary objective), and a lack of deterioration., Occurrence of a visual improvement defined as an increase of two lines or more of visual acuity on ETDRS chart, a clinically significant difference, at W4 and W13, Change in Mean Deviation (MD) measured on an automatized Visual Field (SITA Standard Humphrey 24-2) at weeks 4, 8, and 13., Changes in angio-OCT between baseline and W4: superficial and deep vascular plexus will be examined to look for the decrease of ischemia in peripapillary and macular areas., Proportion of patients with improvement of other manifestations of GCA with tocilizumab and prednisone at weeks 4, 8, and 13., Proportion of patients with biological improvement (i.e. CRP and ESR) with tocilizumab and prednisone at weeks 4, 8, and 13., Influence of 1-month tocilizumab treatment on recurrence of AION, at W13., Influence of 1-month tocilizumab treatment on recurrence of GCA, at W13., Time to first recurrence of GCA, Safety as assessed by adverse events, and serious adverse events., Immunological biomarkers of response to Tocilizumab assessed at W0, W4, and W13.

Source: https://euclinicaltrials.eu/ctis-public/view/2024-519977-20-00